EU clinical trial 2024-512271-13-00: A Phase 3, randomized, modified double-blind, active-controlled, parallel-group study to investigate the safety and immunogenicity of catch-up vaccination regimens of a 21-valent pneumococcal conjugate vaccine in healthy infants, toddlers, children, and adolescents
Protocol code: PSK00010
Sponsor: Sanofi Pasteur Inc. (Pharmaceutical company). Phase: Therapeutic confirmatory (Phase III). Countries: Estonia (ongoing, recruitment ended), Poland (ended).
Therapeutic area(s): Diseases [C] - Bacterial Infections and Mycoses [C01]
Gender: Female, Male. Age: 0-17 years. Enrolment: 710.
Start date (EU): 2025-05-08. Decision date: 2025-03-31. Results received: No. Last updated: 2026-07-28.
Decision dates by country: EE: 2025-03-31, PL: 2025-04-06

Condition(s): Pneumococcal immunisation
Product: PREVNAR 20 ®, Pneumococcal Conjugate Vaccine (PCV)

Primary endpoint: Number of participants reporting immediate adverse events (AEs), Number of participants reporting solicited injection site and solicited systemic reactions, Number of participants reporting unsolicited (spontaneously reported) injection site reactions and unsolicited systemic AEs after each and any injection of a pneumococcal vaccine, Number of participants reporting serious adverse events (SAEs) and adverse events of special interest (AESls), Number of Infants (7-11 months of age [MoA]) and toddlers (12-23 MoA): with serotype-specific lgG concentrations for all serotypes included in PCV21, Number of Children (2-5 years of age [YoA]):with serotype specific OPA titers for all serotypes included in PCV21, Number of Children (2-5 years of age [YoA]):with serotype specific lgG concentrations for all serotypes included in PCV21, Number of Children/adolescents (6-17 YoA):with serotype specific OPA titers for all serotypes included in PCV21
Endpoint(s): Number of Children/adolescents (≥2 YoA) with serotype specific OPA titers for all serotypes included in PCV 21, Number of Children/adolescents (≥2 YoA): with serotype specific lgG concentrations for all serotypes included in PCV21, Number of participants (all age groups) with serotype specific lgG concentration ≥ 0.35 µg/ml for all serotypes included in PCV21, Number of infants (7-11 MoA) and toddlers(12-23 MoA):with serotype specific OPA titers for all serotypes included in PCV21, Percentage of infants (7-11 MoA) and toddlers(12-23 MoA): with serotype specific OPA titers ≥ LLOQ for all serotypes included in PCV21, Number of Children/adolescents (6-17 YoA):with serotype specific lgG concentrations for all serotypes included in PCV21

Source: https://euclinicaltrials.eu/ctis-public/view/2024-512271-13-00